EU clinical trial 2023-504355-28-03: Bioequivalence study of the oral suspension of netupitant/palonosetron combination product versus the hard capsules of netupitant/palonosetron combination product after a single dose administration to healthy male and female volunteers in an open-label, randomised, single centre, 2-treatment, 4-period, 2 sequence replicative design
Protocol code: NEPA-23-01
Sponsor: Helsinn Healthcare S.A., Helsinn Birex Pharmaceuticals Limited (Pharmaceutical company). Phase: Human Pharmacology (Phase I)- Bioequivalence Study. Countries: Germany (ended).
Therapeutic area(s): Not possible to specify
Gender: Female, Male. Age: 18-64 years. Enrolment: 74.
Status: Ended. Start date (EU): 2024-03-14. End date (EU): 2024-09-30. Decision date: 2024-01-10. Results received: No. Last updated: 2024-01-10.

Condition(s): Healthy volunteers

Source: https://euclinicaltrials.eu/ctis-public/view/2023-504355-28-03